EU clinical trial 2024-519176-95-00: A Phase II, single arm Study of avelumab in combination with Axitinib in Patients with unresectable/metastatic Gastrointestinal Stromal Tumor after failure of standard therapy - AXAGIST
Protocol code: AXAGIST
Sponsor: Narodowy Instytut Onkologii Im. Marii Sklodowskiej-Curie Panstwowy Instytut Badawczy (Hospital/Clinic/Other health care facility). Phase: Therapeutic exploratory (Phase II). Countries: Italy (ended), Poland (ended).
Therapeutic area(s): Diseases [C] - Neoplasms [C04]
Gender: Female, Male. Age: 18-64 years, 65+ years. Enrolment: 58.
Status: Ended. Start date (EU): 2019-05-08. End date (EU): 2025-12-31. Decision date: 2025-01-11. Results received: No. Last updated: 2025-01-13.
Decision dates by country: IT: 2025-01-13, PL: 2025-01-11

Condition(s): Gastrointestinal Stromal Tumors (GIST)
Product: Bavencio 20 mg/mL concentrate for solution for infusion, Inlyta 5 mg film-coated tablets, Inlyta 1 mg film-coated tablets

Primary endpoint: Rate of Participants Achieving 3-Month Progression-Free Survival (PFSR) [Rate of participants who are progression-free at 3 months after the start of protocol therapy, using Response Evaluation Criteria In Solid Tumors (RECIST) version 1.1 criteria. Progression-free survival (PFS) is defined as the time from treatment initiation until documented disease progression or death (by any cause, in the absence of progression)].
Endpoint(s): Progression free survival (PFS) [time from treatment initiation to date of first documentation of progression of disease assessed by the Investigator (by RECIST version 1.1) or death due to any cause], Overall survival (OS) [time from the date of treatment initiation until the date of death from any cause], 1-year overall survival (OS) rate [proportion of patients that survive more than 1 year], Overall response rate (ORR) [ORR is defined as the proportion of patients with objective response [confirmed complete (CR) or partial response (PR) according to RECIST Version 1.1], Duration of response (DoR) [the time from documentation of tumor response to disease progression], Disease control rate (DCR) [patients whose best response was CR or PR or Stable Disease (SD)], Adverse events (graded according to the Common Toxicity Criteria for the Adverse Events, CTC-AE, version 4.0) assessed every 4 weeks, Relationship between PDL-1 expression and measures of efficacy, including ORR, DCR, PFS and OS, Relationship between biomarkers in blood/tissue and efficacy, including ORR, DCR, PFS and OS

Source: https://euclinicaltrials.eu/ctis-public/view/2024-519176-95-00